EU clinical trial 2024-515858-25-00: A PHASE 2, SINGLE-ARM STUDY OF THE BIOMARKER EFFECTS OF ALZ-801 IN SUBJECTS WITH EARLY ALZHEIMER’S DISEASE WHO ARE CARRIERS OF THE ε4 VARIANT OF THE APOLIPOPROTEIN E GENE (APOE4/4 or APOE3/4)
Protocol code: ALZ-801-201ADBM
Sponsor: Alzheon Inc. (Pharmaceutical company). Phase: Therapeutic exploratory (Phase II). Countries: Czechia (ended), Netherlands (ended).
Therapeutic area(s): Diseases [C] - Nervous System Diseases [C10]
Gender: Female, Male. Age: 18-64 years, 65+ years. Enrolment: 85.
Status: Ended. Start date (EU): 2020-09-30. End date (EU): 2025-07-16. Decision date: 2024-11-11. Results received: No. Last updated: 2025-08-26.
Decision dates by country: CZ: 2024-11-11, NL: 2024-11-21

Condition(s): Subjects with a clinical diagnosis of Alzheimer's disease who are APOE 4 carriers (APOE4/4, APOE3/4) and at the Early stage of disease, ages 50-80 years
Product: ALZ-801

Primary endpoint: Primary Plasma Biomarker Outcome: change from baseline to Week 104 in plasma biomarker of core AD pathology: p-tau181, Key Imaging Outcome: change from baseline to Week 104 in hippocampal volume on vMRI, Long-Term Extension (Year 1) - Primary Plasma Biomarker Outcome: change from study baseline to Week 156 in plasma biomarkers: p-tau181, Long-Term Extension (Year 1) - Key Imaging Outcome: change from study baseline to Week 156 in hippocampal volume on vMRI, Long-Term Extension (Year 2) - Primary Plasma Biomarker Outcome: change from study baseline to Week 208 in plasma biomarkers: p-tau181, Long-Term Extension (Year 2) - Key Imaging Outcome: change from baseline to Week 208 in hippocampal volume on vMRI
Endpoint(s): Incidence and nature of TEAE, serious TEAE, and TEAE leading to withdrawal, Changes in laboratory parameters, vital signs, and physical examination, Changes in 12-lead electrocardiogram (ECG) parameters, MRI assessments for Amyloid-Related Imaging Abnormalities with edema (ARIA E) or microhemorrhages (ARIA-H), Secondary Fluid Biomarker Outcome - Change from baseline to Week 104 in plasma biomarkers of other core AD pathologies: Aβ40, Aβ42, and p-tau217, Secondary Imaging Biomarker Outcome - Change from baseline to Week 104 in cortical thickness and ventricular volume, Exploratory Fluid Biomarker Outcomes - Change from baseline to Week 104 in biomarker of plasma GFAP, Change from baseline to Week 104 in plasma NfL, Change from baseline to Week 104 in CSF p-tau181, p-tau217, Aβ40, and Aβ42, Change from baseline to Week 104 in CSF neurogranin, Change from baseline to Week 104 in CSF t-tau and NfL, Change from baseline to Week 104 in CSF TREM2 and YKL-40, Clinical Outcomes - Change from baseline to Week 104 in RAVLT, DSST, A-IADL MMSE, CDR-SB, Pharmacokinetic and Pharmacodynamic Outcomes - Plasma and CSF levels of ALZ-801, tramiprosate, and its metabolite before and after first dose, at steady state, and at later time points in the study. PK non-compartmental analysis will be performed using Phoenix WinNonlin (version 7.0 or later)., Correlation of PK levels to biomarker outcomes., Correlation of PK levels to efficacy and safety parameters., Extended PK profile over 8 hours on Week 65 will be evaluated in approximately 24 subjects (approximately 12 APOE4/4 homozygotes and 12 APOE3/4 heterozygotes) who have consented to participate in the PK Profile Substudy., Additional Fluid and Imaging Biomarker Outcomes - Change from baseline to Weeks 6, 13, 26, 52, and 78 for plasma biomarkers, Change from baseline to Week 52 in hippocampal volume, cortical thickness, and ventricular volume, Change from baseline to Week 52 and 104 in other exploratory MRI imaging outcomes (to be described in the SAP), Change from baseline to Week 52 for CSF biomarkers, Additional Clinical Outcomes - Change from baseline to Weeks 13, 26, 52, and 78 for RAVLT and DSST, Change from baseline to Weeks 13, 26, 39, 52, 65, 78, and 91 for MMSE, Change from baseline to Week 52 for A-IADL and CDR-SB, Long-Term Extension (Year 1) - Safety Outcomes - Safety and tolerability over 156 weeks of study and over 52 weeks of the LTE Year 1 as listed in Section 2.2.2, Secondary Fluid Biomarker Outcome - Change from study baseline to Week 156 in plasma biomarkers: p-tau217, Aβ40, and Aβ42, Secondary Imaging Biomarker Outcome - Change from study baseline to Week 130 in hippocampal volume, Change from baseline to Weeks 130 and 156 on cortical thickness, whole brain volume and ventricular volume on vMRI, Exploratory Fluid Biomarkers Outcomes - Change from baseline to Week 156 in plasma GFAP, Change from baseline to Week 156 in plasma NfL, Change from baseline to Week 156 in CSF p-tau181, p-tau217, Aβ40, and Aβ42, Change from baseline to Week 156 in CSF neurogranin, Change from baseline to Week 156 in CSF t-tau and NfL, Change from baseline to Week 156 in CSF sTREM2 and YKL-40, Clinical Outcomes - Change from baseline to Weeks 130 and 156 in the clinical outcomes: RAVLT, DSST, MMSE, A-IADL, and CDR-SB, Pharmacokinetic Outcomes - PK assessments for ALZ-801 and its metabolites as in Section 2.2.7, Additional Fluid and Imaging Biomarker Outcomes - Change from baseline to Week 130 in plasma biomarkers: GFAP, NfL, p-tau181, p-tau217, Aβ40, and Aβ42, Change from baseline to Weeks 130 and 156 in other exploratory MRI imaging outcomes (as described in the SAP), Change from LTE baseline (Week 104) to Weeks 130 and 156 in MRI diffusion tensor imaging (DTI), Long-Term Extension (Year 2) - Safety Outcomes - Safety and tolerability over 104 weeks of the LTE-assessments (and over 208 weeks in the overall study) as listed in Section 2.2.2, Secondary Fluid Biomarker Outcome - Change from baseline to Week 208 in plasma biomarkers: p-tau217, Aβ40, and Aβ42, Secondary Imaging Biomarker Outcome - Change from baseline to Week 182 in hippocampal volume, Change from baseline to Weeks 182 and 208 in cortical thickness, whole brain volume and ventricular volume on vMRI, Exploratory Fluid Biomarkers Outcomes - Change from baseline to Week 208 in plasma GFAP, Change from baseline to Week 208 in plasma NfL, Clinical Outcomes - Change from baseline to Weeks 168, 182, 196, and 208 in the clinical outcomes: RAVLT, DSST, MMSE, A-IADL, and CDR-SB, Change from baseline on the NPI: change from the first clinic assessment of the NPI to assessments at all later visits, Pharmacokinetic Outcomes - PK assessments for ALZ-801 and its metabolites as in Section 2.2.7, Additional Fluid and Imaging Biomarker Outcomes - Change from baseline to Weeks 168, 182, 196 in plasma biomarkers: GFAP, NfL, p-tau181, p-tau217, Aβ40, and Aβ42, Change from baseline to Weeks 182 and 208 in other exploratory MRI imaging outcomes (as described in the SAP), Change from LTE Year 1 baseline (Week 104) to Weeks 130, 156, 182, and 208 in MRI DTI measures.

Source: https://euclinicaltrials.eu/ctis-public/view/2024-515858-25-00